EU clinical trial 2022-501006-34-01: ALB-TRIAL: Personalized Long-term Human Albumin Treatment in Patients With Decompensated Cirrhosis and Ascites
Sponsor: Odense University Hospital, European Foundation For The Study Of Chronic Liver Failure (Hospital/Clinic/Other health care facility, Patient organisation/association). Phase: Therapeutic confirmatory (Phase III). Countries: Hungary (ongoing, recruiting), Netherlands (ongoing, recruiting), Spain (ongoing, recruiting), Germany (ongoing, recruiting), Belgium (ongoing, recruiting), Denmark (ongoing, recruiting), Slovakia (authorised, recruitment pending).
Therapeutic area(s): Diseases [C] - Digestive System Diseases [C06]
Gender: Female, Male. Age: 18-64 years, 65+ years. Enrolment: 210.
Start date (EU): 2023-03-29. Decision date: 2023-02-13. Results received: No. Last updated: 2025-10-07.
Decision dates by country: HU: 2023-02-16, ES: 2023-02-15, NL: 2023-02-13, DE: 2023-02-15, BE: 2023-02-13, DK: 2023-02-13, SK: 2025-06-10

Condition(s): Liver cirrhosis
Product: Salina Fisiológica Grifols 0,9% Solución para perfusión Cloruro de sodio, Human Albumin Grifols 200 g/l, solution for infusion.

Primary endpoint: Cumulative number of liver-related clinical outcomes (variceal bleeding, ascites, spontaneous bacterial peritonitis, infection requiring hospitalization, acute kidney injury and overt hepatic encephalopathy) and TIPS (insertion or revision) with death and liver transplantation as counting and censoring events
Endpoint(s): 6-months survival, The number of episodes of acute-on-chronic liver failures, Number of organ failures, Time-to-first liver-related clinical outcome, Patients’ quality of life, Time to first hospital admission (in days), Number of hospital admissions, Days spent on hospitalization (in days), Number of intensive care unit admissions, Length of intensive care unit admissions (in days), Number of large volume paracentesis, Analysis of the cost/effectiveness ratio, Health economic evaluation, Changes in serum albumin levels, Number of treatment-related adverse events, Number of treatment-related serious adverse events, Signatures associated with a poor prognosis as defined by the Microb-Predict biomarker, Incidence of refractory ascites, Incidence of variceal bleeding, Incidence of spontaneous bacterial peritonitis, Incidence of infection requiring hospitalization, Incidence of acute kidney injury >= 1B, Incidence of hepatorenal syndrome acute kidney injury, Incidence of overt hepatic encephalopathy, Incidence of liver transplantation, Incidence of TIPS insertion or revision

Source: https://euclinicaltrials.eu/ctis-public/view/2022-501006-34-01